EU clinical trial 2023-507188-21-00: A Phase 3, Multi-center, Randomized Study Evaluating Efficacy of TAR-200 in Combination With Cetrelimab Versus Concurrent Chemoradiotherapy in Participants With Muscle-Invasive Urothelial Carcinoma (MIBC) of the Bladder who are not Receiving Radical Cystectomy
Protocol code: 17000139BLC3001
Sponsor: Janssen - Cilag International (Pharmaceutical company). Phase: Therapeutic confirmatory (Phase III). Countries: Austria (ongoing, recruitment ended), Czechia (ended), France (ongoing, recruitment ended), Germany (ongoing, recruitment ended), Spain (ended), Portugal (ended), Belgium (ended), Hungary (ended), Italy (ended), Greece (ongoing, recruitment ended).
Therapeutic area(s): Diseases [C] - Neoplasms [C04]
Gender: Female, Male. Age: 18-64 years, 65+ years. Enrolment: 171.
Start date (EU): 2021-04-20. Decision date: 2024-06-07. Results received: No. Last updated: 2026-07-20.
Decision dates by country: PT: 2024-06-07, CZ: 2024-06-11, HU: 2024-06-07, BE: 2024-06-07, ES: 2024-06-10, IT: 2024-07-01, AT: 2024-06-11, GR: 2024-07-02, DE: 2024-06-11, FR: 2024-06-07

Condition(s): Muscle-Invasive Urothelial Carcinoma (MIBC) of the Bladder
Product: Gemcitabine100 mg/ml Concentrate for Solution for Infusion, Cisplatinum Accord, 1 mg/ml, koncentrat do sporządzania roztworu do infuzji., JNJ-17000139, GEMCITABINE ACCORD 100 mg/ml, solution à diluer pour perfusion, Gemcitabin Accord 100 mg/ml Konzentrat zur Herstellung einer Infusionslösung, JNJ-63723283, Gemcitabina Accord 100 mg/ml concentrato per soluzione per infusione., JNJ-63723283

Primary endpoint: Time from randomization to the first BI-EFS event, including histologically proven presence of muscle-invasive bladder cancer (MIBC), clinical evidence of nodal or metastatic disease (as assessed by RECIST 1.1 criteria), radical cystectomy (RC), or death due to any cause
Endpoint(s): Time from randomization to first radiologic (as assessed by RECIST 1.1 criteria) or evidence of metastatic disease or death due to any cause, Time from randomization to death, The ORR is defined as the proportion of participants who achieve a CR or PR, Frequency and grade of adverse events (AEs) and according to Patient-Reported Outcomes version of the Common Terminology Criteria for Adverse Events (NCI PRO-CTCAE). NCI PROCTCAE assessments will be done for all urinary and all gastrointestinal items in the NCI PRO-CTCAE item library. Laboratory abnormalities:CTCAE grades and NCI PRO-CTCAE grades comparing baseline to the worst post-baseline value.

Source: https://euclinicaltrials.eu/ctis-public/view/2023-507188-21-00